EU clinical trial 2023-509167-24-00: BYLieve: A phase II, multicenter, open-label, three-cohort, non-comparative study to assess the efficacy and safety of alpelisib plus fulvestrant or letrozole in patients withPIK3CA mutant, hormone receptor (HR) positive, HER2-negative advanced breast cancer (aBC), who have progressed on or after prior treatments.
Protocol code: CBYL719X2402
Sponsor: Novartis Pharma AG (Pharmaceutical company). Phase: Therapeutic exploratory (Phase II). Countries: Denmark (ended), Italy (ended).
Therapeutic area(s): Diseases [C] - Neoplasms [C04]
Gender: Female, Male. Age: 18-64 years, 65+ years. Enrolment: 2.
Status: Ended. Start date (EU): 2017-10-02. End date (EU): 2024-11-12. End date: 2024-11-13. Decision date: 2024-03-22. Results received: Yes. Last updated: 2024-03-28.
Decision dates by country: DK: 2024-03-22, IT: 2024-03-28

Condition(s): Adult patients with PIK3CA mutant, HR-positive, HER2-negative advanced breast cancer
Product: ALPELISIB, FULVESTRANT, ALPELISIB, LETROZOLE, LEUPRORELIN ACETATE, GOSERELIN

Primary endpoint: The primary endpoint of this study is the proportion of patients who are alive without disease progression at 6 months based on local investigator assessment using RECIST v1.1 in each cohort
Endpoint(s): PFS based on local investigator assessment using RECIST v1.1 in each cohort, PFS2 based on local investigator assessment in each cohort, ORR based on local investigator’s assessment according to RECIST v1.1 in each cohort Clinical Benefit Rate (CBR) based on local investigator’s assessment according to RECIST v1.1 in each cohort, Duration of Response is the time from the date of first documented response (confirmed CR or PR) to the date of first documented progression or death, Overall Survival is defined as the time of start of treatment to date of death or lost to follow-up, Type, frequency and severity of adverse events per CTCAE v4.03 Type, frequency and severity of laboratory toxicities per CTCAE v4.03, Proportion of patients with clinical benefit as assessed by the Investigator at scheduled visits

Source: https://euclinicaltrials.eu/ctis-public/view/2023-509167-24-00